EU clinical trial 2023-507560-39-00: Phase 3, double-blind, placebo-controlled, multicentre study on the efficacy and safety of human plasma derived antithrombin (Atenativ) in heparin-resistant patients scheduled to undergo cardiac surgery necessitating cardiopulmonary bypass
Protocol code: ATN-108
Sponsor: Octapharma AG (Pharmaceutical company). Phase: Therapeutic confirmatory (Phase III). Countries: Lithuania (ongoing, recruiting), Slovenia (ongoing, recruiting), Austria (ongoing, recruiting), Romania (ongoing, recruiting), Czechia (ongoing, recruiting), France (ended), Spain (ongoing, recruiting), Poland (authorised, recruitment pending).
Therapeutic area(s): Diseases [C] - Cardiovascular Diseases [C14]
Gender: Female, Male. Age: 18-64 years, 65+ years. Enrolment: 53.
Start date (EU): 2025-01-07. Decision date: 2024-08-01. Results received: No. Last updated: 2026-07-21.
Decision dates by country: CZ: 2024-08-05, RO: 2024-08-06, FR: 2024-08-06, SI: 2024-08-01, LT: 2024-08-05, AT: 2024-08-05, ES: 2026-03-27, PL: 2026-04-09

Condition(s): Acquired Antithrombin Deficiency (Heparin Resistance)
Product: Atenativ 50 TV/ml milteliai ir tirpiklis infuziniam tirpalui, Atenativ 1000 I.E. - Pulver und Lösungsmittel zur Herstellung einer Injektions- oder Infusionslösung, Atenativ 50 UI/ml pulbere și solvent pentru soluție perfuzabilă, Atenativ 50 i.e./ml prašek in vehikel za raztopino za infundiranje, ATENATIV 50 UI/mL, poudre et solvant pour solution pour perfusion, Atenativ 50 TV/ml milteliai ir tirpiklis infuziniam tirpalui, Isotone Natriumchloridlösung 0,9 % Braun Injektionslösung, Atenativ, 50 IU/ml, prášek a rozpouštědlo pro infuzní roztok, ATENATIV 50 UI/mL, poudre et solvant pour solution pour perfusion, Atenativ 50 UI/ml pulbere și solvent pentru soluție perfuzabilă, Atenativ 50 i.e./ml prašek in vehikel za raztopino za infundiranje, Atenativ 500 I.E. - Pulver und Lösungsmittel zur Herstellung einer Injektions- oder Infusionslösung, Atenativ 50 IU/ml prášek a rozpouštědlo pro infuzní roztok

Primary endpoint: The primary efficacy endpoint is the percentage of patients in each group in whom no further therapy containing antithrombin (i.e., FP or other antithrombin concentrates) is needed for restoring pre-CPB heparin responsiveness after administration of Atenativ or placebo, and for maintaining it during CPB.
Endpoint(s): The comparison between the amounts of further therapy containing antithrombin (i.e., FP or antithrombin concentrates) needed for restoring pre-CPB heparin responsiveness after administration of Atenativ or placebo, and for maintaining it during CPB, The comparison between the change in ACT values following infusion of each of the Atenativ doses and placebo, The comparison between the change in antithrombin plasma levels following infusion of each of the Atenativ doses and placebo, The comparison between heparin usage following the infusion of each of the Atenativ doses and placebo, The comparison between the number of units of FP transfused for reasons other than restoring or maintaining heparin responsiveness, both intraoperatively (from the start of Atenativ or placebo infusion until the start of CPB, during CPB, and from the end of CPB until the end of surgery) and postoperatively (from the end of surgery until 24 hours after the start of Atenativ or placebo infusion and until discharge or 7 days after surgery, whichever comes first), as well as cumulatively, The comparison between postoperative use of antithrombin concentrates for reasons other than restoring heparin responsiveness (from the end of surgery until 24 hours after the start of Atenativ or placebo infusion and until discharge or 7 days after surgery, whichever comes first), The comparison between transfusion of other allogeneic blood products (i.e., red blood cells [RBCs], platelets, cryoprecipitate, whole blood, albumin, other transfusion), both intraoperatively and postoperatively, as well as cumulatively, The comparison between administration of coagulation factor concentrates (fibrinogen concentrate, prothrombin complex concentrate (PCC), factor XIII concentrate, recombinant activated factor VII, other therapy), both intraoperatively and postoperatively, as well as cumulatively, The comparison between administration of other haemostatic-relevant therapies (i.e., tranexamic acid, aminocaproic acid, protamine, other therapies), both intraoperatively and postoperatively, as well as cumulatively, The comparison between postoperative chest tube drainage volume at 24 hours after the start of Atenativ or placebo infusion, and the comparison between total chest tube drainage volume until discharge or 7 days after surgery, whichever comes first, Comparison of the need for reoperation for bleeding, including description of the cause of bleeding (surgical vs. non-surgical), The comparison between cell saver volume until the end of surgery, Incidence of AEs in the three study groups, Standard haematological parameters (i.e., RBC count, white blood cell count, haemoglobin levels, haematocrit, and platelet count) following Atenativ or placebo infusion, after the end of CPB, at the end of surgery, and at 24 hours after the start of Atenativ or placebo infusion, Survival status in the different treatment groups., The comparison between the amounts of further therapy containing antithrombin (i.e., FP or antithrombin concentrates) needed for restoring heparin responsiveness from the end of CPB until 24 hours after start of Atenativ or placebo infusion and from the end of CPB until discharge or 7 days postoperatively, whichever comes first, Comparison of the length of ICU stay between treatment groups.

Source: https://euclinicaltrials.eu/ctis-public/view/2023-507560-39-00